EU clinical trial 2024-515634-32-00: A PHASE 1/2, DOSE AND SCHEDULE EVALUATION STUDY TO INVESTIGATE THE SAFETY AND CLINICAL ACTIVITY OF BELANTAMAB MAFODOTIN ADMINISTERED IN COMBINATION WITH DARATUMUMAB, LENALIDOMIDE AND DEXAMETHASONE IN PATIENTS WITH NEWLY DIAGNOSED MULTIPLE MYELOMA TRANSPLANT INELIGIBLE
Protocol code: EAE120
Sponsor: Hellenic Society Of Hematology (Patient organisation/association). Phase: Phase I and Phase II (Integrated)- Other. Countries: Greece (ongoing, recruitment ended).
Therapeutic area(s): Diseases [C] - Neoplasms [C04]
Gender: Female, Male. Age: 18-64 years, 65+ years. Enrolment: 36.
Status: Ongoing, recruitment ended. Start date (EU): 2022-03-31. Decision date: 2024-09-23. Results received: No. Last updated: 2025-11-04.

Condition(s): newly diagnosed multiple myeloma
Product: DEXAMETHASONE, DEXAMETHASONE, LENALIDOMIDE, DARATUMUMAB

Primary endpoint: The description of the primary endpoint exceeds the number of allowed characters in this field. Please refer to the protocol enclosed in this application
Endpoint(s): •Lenalidomide RDI; DLT evaluable population, safety population, •Cumulative belantamab mafodotin dose of (DLT evaluable population, safety population) administered in combination with daratumumab, lenalidomide and dexamethasone. The total dose for each participant will be calculated as the sum of all administrated doses, •ORR and 95% CI as per IMWG by Investigator Assessment (ITT population) Part 1 only, •VGPR+ and 95% CI as per IMWG by Investigator Assessment (ITT population) Part 1 only, •TTR as per IMWG by Investigator Assessment (ITT population), •DoR as per IMWG by Investigator Assessment (ITT population). The median DoR will be presented along with the respective 95% CIs and the 1st and 3rd quartiles., •CRR as per IMWG by Investigator Assessment (ITT population).The denominator will be the total number of participants in each population, cohort and group respectively., •MRD negativity rate (ITT population). The denominator will be the total number of participants in each population, cohort and Group respectively., •PFS as per IMWG by Investigator Assessment (ITT population, Safety population). The median PFS will be analyzed with the Kaplan Meier method and presented along with the respective 95% CI and the 1st and 3rd quartiles., •OS (ITT population, Safety population). The median OS will be analyzed using the Kaplan-Meier method and will be presented with the respective 95% CI and the 1st and 3rd quartiles., •Number (%) of participants with abnormal ocular findings (DLT evaluable population, Safety population)., •PK analysis (PK population) Concentration-time data: linear and semi-logistic unique profiles of concentration-time and the mean and median profiles will be graphically represented for belantamab mafodotin. PK parameters: Concentration-time data can be presented, considering data from other studies and analyzed using a population PK analysis. Further, the Cmax and AUC will be calculated., •Number of participants with changes from baseline and proportion of participants with within-participant meaningful change in self reported ocular symptoms and related impacts as measured by the OSDI questionnaire., •Alternate corneal AE management: KVA events, dose holds, worst postbaseline BCVA and incidence of Grade 4 corneal findings will be descriptively summarized using frequencies and proportions. Exploratory Endpoints

Source: https://euclinicaltrials.eu/ctis-public/view/2024-515634-32-00